EU clinical trial 2024-514420-16-00: Randomized phase 2 study of Valproic acid combinEd with rechallenge anti-EGFR based regimen regimens in pretreated patients with RAS/BRAF wild-type metastatic colorectal cancer (VICTORIA)
Sponsor: IRCCS Istituto Nazionale Tumori Fondazione Pascale (Hospital/Clinic/Other health care facility). Phase: Therapeutic exploratory (Phase II). Countries: Italy (ongoing, recruiting).
Therapeutic area(s): Diseases [C] - Digestive System Diseases [C06]; Diseases [C] - Neoplasms [C04]
Gender: Female, Male. Age: 18-64 years, 65+ years. Enrolment: 130.
Status: Ongoing, recruiting. Start date (EU): 2024-12-18. Decision date: 2024-09-16. Results received: No. Last updated: 2026-04-29.

Condition(s): RAS/BRAF wild-type metastatic colorectal cancer
Product: Vectibix 20 mg/ml concentrate for solution for infusion, VALPROIC ACID, VALPROIC ACID, Irinotecan Accord 20 mg/ml concentrato per soluzione perinfusione

Primary endpoint: Study Part 1_Progression-free survival (PFS) rate at 16 weeks: measured as the time from the date of randomization until the date of the first observation of disease progression or death due to any cause, whichever occurs first., Study Part 2_PFS rate at 8 weeks: defined as the rate of assessable patients alive and not progressed after 8 weeks from initiation of VICTORIA - Study Part 2 (i.e End of Treatment Visit with documentation of progression to VICTORIA - Study Part 1, for patients randomized to ARM A - standard treatment).
Endpoint(s): Study Part 1: Objective Tumor Response Rate (ORR) assessed according to RECIST criteria 1.1., Study Part 1: Disease Control Rate (DCR) defined as the proportion of patients with complete/partial response and stable disease as their best response., Study Part 1: Progression-free survival (PFS) measured as the time from the date of randomization until the date of the first observation of disease progression or death due to any cause, whichever occurs first., Study Part 1: Overall survival (OS) calculated as the time from the date of randomization until the date of death from any cause., Study Part 1: Safety evaluated as adverse events graded according NCI CTCAE v. 5.0., Study Part 1: Quality of life (QoL) investigated through the EORTC QLQ-C30 and CR29 questionnaires., Study Part 1: Patient Report Outcome (PRO)-CTCAE with items dedicated in particular to diarrhea and skin toxicity to evaluate the effect of the treatment on the health-related QoL., Study Part 2: Progression-free survival (PFS) measured as the time from the date from initiation of VICTORIA - Study Part 2 (i.e. at End of Treatment Visit with documentation of progression to VICTORIA - Study Part 1) until the date of the first observation of disease progression or death due to any cause, whichever occurs first., Study Part 2: Overall survival (OS) calculated as the time from the date from initiation of VICTORIA - Study Part 2 (i.e. at End of Treatment Visit with documentation of progression to VICTORIA - Study Part 1) until the date of death from any cause., Study Part 2: Objective Tumor Response Rate (ORR) assessed according to RECIST criteria 1.1., Study Part 2: Disease Control Rate (DCR) defined as the proportion of patients with complete/partial response and stable disease as their best response., Study Part 2: Safety evaluated as adverse events graded according NCI CTCAE v 5.0., Study Part 2: Quality of life (QoL) investigated through the EORTC QLQ-C30 and CR29 questionnaires., Study Part 2: Patient Report Outcome (PRO)-CTCAE with items dedicated in particular to diarrhea and skin toxicity to evaluate the effect of the treatment on the health-related QoL.

Source: https://euclinicaltrials.eu/ctis-public/view/2024-514420-16-00